EU clinical trial 2023-508432-53-00: SUBCUTANEOUS INJECTIONS OF CULTURED ADIPOSE-DERIVED STROMA/ STEM CELLS TO HEAL REFRACTORY ISCHEMIC DIGITAL ULCERS IN PATIENTS WITH SCLERODERMA: A PHASE II STUDY
Protocol code: RC31/17/0447
Sponsor: Centre Hospitalier Universitaire De Toulouse (Hospital/Clinic/Other health care facility). Phase: Therapeutic exploratory (Phase II). Countries: France (ongoing, recruiting).
Therapeutic area(s): Diseases [C] - Immune System Diseases [C20]
Gender: Female, Male. Age: 18-64 years. Enrolment: 32.
Status: Ongoing, recruiting. Start date (EU): 2020-09-22. Decision date: 2023-10-27. Results received: No. Last updated: 2026-01-19.

Condition(s): Systemic sclerosis
Product: 5 ml containing 5% human albumin and Cryostor®CS10, CellReady

Primary endpoint: Proportion of refractory active ischemic digital ulcers healed (complete or partial) without recurrence at 16 weeks. The main evaluation criterion is a composite endpoint combining healing (complete or partial) without recurrence at 16 weeks and without local or general complications.

Source: https://euclinicaltrials.eu/ctis-public/view/2023-508432-53-00